EU clinical trial 2025-521571-30-00: PREV-CART - A multicentric phase III randomized clinical trial open-label, comparing immunoglobulin replacement therapy (IgRT) and antibiotic prophylaxis (AP) in patients treated by CD19-targeted Chimeric Antigen Receptor (CAR)T Cells for a B cell acute lymphoblastic leukemia or a B cell lymphoma
Protocol code: APHP241013
Sponsor: Assistance Publique Hopitaux De Paris (Hospital/Clinic/Other health care facility). Phase: Therapeutic confirmatory (Phase III). Countries: France (authorised, recruitment pending).
Therapeutic area(s): Diseases [C] - Hemic and Lymphatic Diseases [C15]
Gender: Female, Male. Age: 0-17 years, 18-64 years, 65+ years. Enrolment: 228.
Status: Authorised, recruitment pending. Decision date: 2026-04-13. Results received: No. Last updated: 2026-04-13.

Condition(s): Young Adults and adults with R/R B-cell acute lymphoblastic leukemia (BCP-ALL) or a B cell lymphoma (BCL)
Product: AMOXICILLIN TRIHYDRATE, SULFAMETHOXAZOLE AND TRIMETHOPRIM, LEVOFLOXACIN, AMOXICILLIN, AZITHROMYCIN, AZITHROMYCIN, IMMUNOGLOBULINS, NORMAL HUMAN, FOR INTRAVASCULAR ADM., LEVOFLOXACIN

Primary endpoint: A composite outcome defined by the occurrence of either recurrent infections (defined by at least 2 episodes requiring a curative systemic antibiotic treatment) or a severe infection (defined by the need of hospitalization) between randomization and M12.
Endpoint(s): - Cumulative hazard of severe (requiring hospitalization) infections within 12 months, - Infection-free survival rate at M12, - Occurrence of COVID19 infection within 12 months, - Cumulative incidence of readmissions due to infectious episode after hospital discharge following the infusion of CAR-T cells within 12 months, - Incidence of adverse events due to IgRT and/or PA between randomization and M12, - Measures of IgA, IgG, IgM, CD19/CD4/CD8 lymphocytes counts at lymphodepletion, M1, M3, M6, M9, M12, - Quality of life measured on QLQ-C30 and EQ5D5L, - Cost effectiveness and cost utility: incremental cost effectiveness/utility ratios

Source: https://euclinicaltrials.eu/ctis-public/view/2025-521571-30-00